EU clinical trial 2023-504265-23-00: A PHASE 2, MULTI-CENTER, DOUBLE-BLIND, TWO-ARM STUDY OF SUBCUTANEOUS RO7790121 FOR THE TREATMENT OF SUBJECTS WITH MODERATE TO SEVERE ACTIVE CROHN’S DISEASE
Protocol code: GA45392/RVT-3101-201
Sponsor: F. Hoffmann-La Roche AG (Pharmaceutical company). Phase: Therapeutic exploratory (Phase II). Countries: Slovakia (ended), Italy (ended), Germany (ended), Belgium, France (ongoing, recruitment ended), Czechia (ended), Poland (ongoing, recruitment ended), Bulgaria (ended), Hungary (ended), Spain (ended), Netherlands (ended).
Therapeutic area(s): Diseases [C] - Digestive System Diseases [C06]
Gender: Female, Male. Age: 18-64 years, 65+ years. Enrolment: 70.
Start date (EU): 2023-10-23. Decision date: 2023-10-03. Results received: No. Last updated: 2026-02-24.
Decision dates by country: BG: 2023-10-09, DE: 2023-10-04, HU: 2023-10-09, BE: 2023-10-03, CZ: 2023-10-05, IT: 2023-10-04, ES: 2023-10-09, NL: 2023-10-09, SK: 2023-10-04, PL: 2023-10-09, FR: 2023-10-05

Condition(s): Crohn's disease
Product: RVT-3101, RO7790121

Primary endpoint: Participant incidence of TEAEs, SAEs, and AEs leading to discontinuation throughout study
Endpoint(s): Proportion of participants achieving endoscopic response defined as a decrease in SES-CD ≥50% from the Baseline at W14, assessed by central read, Proportion of participants achieving clinical remission (CDAI <150) at W14, Proportion of participants achieving clinical remission by PRO2 (average daily very soft or liquid SF ≤2.8 and AP score ≤1, and not worse than the Baseline) at W14, PK parameters of RO7790121 (e.g., Ctrough)

Source: https://euclinicaltrials.eu/ctis-public/view/2023-504265-23-00